EU clinical trial 2023-507295-40-00: Biomarker-Guided Early Clarithromycin Treatment To Prevent Sepsis Progression In Community-Acquired Pneumonia: The REACT Randomized Clinical Trial
Protocol code: REACT
Sponsor: Hellenic Institute For The Study Of Sepsis (Laboratory/Research/Testing facility). Phase: Therapeutic confirmatory (Phase III). Countries: Greece (ongoing, recruiting).
Therapeutic area(s): Diseases [C] - Respiratory Tract Diseases [C08]
Gender: Female, Male. Age: 18-64 years, 65+ years. Enrolment: 330.
Status: Ongoing, recruiting. Start date (EU): 2024-02-12. Decision date: 2024-01-31. Results received: No. Last updated: 2026-07-28.

Condition(s): Community-acquired pneumonia
Product: Placebo for Clarithomycin film-coated tablets (500mg), KLARICID® 500 mg επικαλυμμένα με λεπτό υμένιο δισκία

Primary endpoint: This is defined on day 4 and it is a composite endpoint of three conditions. Only patients meeting ALL three conditions will be considered as succeeding the primary endpoint., Condition A RSS i.e. the sum of scoring for the symptoms of cough, dyspnea, purulent sputum expectoration and pleuritic chest pain on visit 4 is decreased by at least 50% from the baseline score of day 1 without the development of any new symptom, Condition B SOFA score on visit 4 is decreased by at least 30% from the baseline SOFA score of day 1, Condition C Combination of: (Plasma PCT on visit 4 has decreased by at least 80% from baseline PCT on screening or it is below 0.25 ng/ml) AND ([plasma IL-10 on visit 4 has decreased by at least 25% from IL-10 of visit 1 or it is below the lower limit of detection] or [the IL-8 to IL-10 ratio of day 4 has decreased less than 15% from the IL- 8 to IL-10 ratio of visit 1])., It is explicitly stated that patients dying prior to day 4 are considered failing the primary endpoint.
Endpoint(s): Development of new organ dysfunctions until day 28, Progression into sepsis, Clinical success at the TOC visit; this is also analyzed separately for patients infected or colonized by clarithromycin-susceptible and clarithromycin-resistant S.pneumoniae, Need for up-escalation of the SoC administered antibiotics. This is considered as the change of the baseline administered SoC antibiotics into more broad-spectrum antibiotics., Alive hospital discharge until day 28, Achievement of more than 50% decrease of baseline SOFA score at EOT visit, Score of improvement of CAP-associated immune dysregulation (see sections of Laboratory procedures) at the EOT visit, Change of cytokine production by PBMCs: IL -6, IL-8, IL-10, TNFα on day 4 from visit 1., Association of 28-day mortality with the score of improvement of CAP-associated immune dysregulation, Association of 90-day mortality with score of improvement of CAP- associated immune dysregulation, Cost of hospital stay, Comparison of 28-day mortality between screening failure patients due to SuPAR <6 ng/ml and/or PCT <0.25 ng/ml, and patients randomized to the placebo group

Source: https://euclinicaltrials.eu/ctis-public/view/2023-507295-40-00